EU clinical trial 2024-516057-42-00: Intravenous immunoglobulin and prednisone vs. prednisone in newly diagnosed myositis: a double blind randomized clinical trial
Sponsor: Stichting Amsterdam UMC (Hospital/Clinic/Other health care facility). Phase: Therapeutic exploratory (Phase II). Countries: Netherlands (ended).
Therapeutic area(s): Diseases [C] - Musculoskeletal Diseases [C05]; Diseases [C] - Immune System Diseases [C20]
Gender: Female, Male. Age: 18-64 years, 65+ years. Enrolment: 48.
Status: Ended. Start date (EU): 2024-10-10. End date (EU): 2026-07-15. Decision date: 2024-10-10. Results received: No. Last updated: 2024-10-10.

Condition(s): Idiopathic inflammatory myopathy
Product: Natriumchloride 0,9 % m/v, oplossing voor infusie, Nanogam 100 mg/ml oplossing voor infusie

Primary endpoint: treatment response at 12 weeks, measured by 'total improvement score'
Endpoint(s): Health related quality of life (HR-QoL) is measured by EQ-5D., Physical functioning is measured by accelerometry., Biomarker (imaging): assess the presence of muscle edema as a marker of disease activity by whole body muscle MRI, Biomarker (blood): interferon biomakers (CXCL-10, galectin-9 and Siglec-1), IgG blood levels

Source: https://euclinicaltrials.eu/ctis-public/view/2024-516057-42-00